EU clinical trial 2024-519835-41-00: A study to compare the absorption of two tablet strengths with the absorption of a solution.
Protocol code: ARV-102-104
Sponsor: Arvinas Operations Inc. (Pharmaceutical company). Phase: Human Pharmacology (Phase I)- Bioequivalence Study. Countries: Netherlands (ended).
Therapeutic area(s): Phenomena and Processes [G] - Musculoskeletal and Neural Physiological Phenomena [G11]
Gender: Female, Male. Age: 18-64 years. Enrolment: 18.
Status: Ended. Start date (EU): 2025-02-28. End date (EU): 2025-06-25. Decision date: 2025-02-27. Results received: No. Last updated: 2025-04-09.
Decision dates by country: NL: 2025-04-09

Condition(s): Parkinson's Disease

Source: https://euclinicaltrials.eu/ctis-public/view/2024-519835-41-00